EU clinical trial 2024-514635-26-00: A clinical trial in children and adolescents with primary malignant liver cancer - Hepatoblastoma and Hepatocarcinoma
Protocol code: NBK151/1/2022
Sponsor: Medical University Of Gdansk (Educational Institution). Phase: Therapeutic confirmatory (Phase III). Countries: Poland (ongoing, recruiting).
Therapeutic area(s): Diseases [C] - Neoplasms [C04]
Gender: Female, Male. Age: 0-17 years, 18-64 years. Enrolment: 60.
Status: Ongoing, recruiting. Start date (EU): 2025-08-28. Decision date: 2024-11-05. Results received: No. Last updated: 2025-06-05.

Condition(s): Hepatoblastoma and liver cancer (hepatocarcinoma)
Product: IRINOTECAN, OXALIPLATIN, Pedmark, CISPLATIN, CARBOPLATIN, FLUOROURACIL, SORAFENIB, DOXORUBICIN, ETOPOSIDE, VINCRISTINE, GEMCITABINE

Primary endpoint: Depend on the Study Group: event-free survival, overall survival, adherence to surgical guidelines, chemotherapy-related toxicity, hearing loss, response, failure-free survival, surgical resectability.

Source: https://euclinicaltrials.eu/ctis-public/view/2024-514635-26-00